EU clinical trial 2023-507336-20-00: A Phase III, Multicentre, International Study with a Parallel, Randomised, Double blind, Placebo-controlled, 2 Arm Design to Assess the Efficacy and Safety of Selumetinib in Adult Participants with NF1 who have Symptomatic, Inoperable Plexiforn Neurofibromas (KOMET)
Protocol code: KOMET D134BC00001
Sponsor: Astrazeneca AB (Pharmaceutical company). Phase: Therapeutic confirmatory (Phase III). Countries: Germany (ended), Spain (ongoing, recruitment ended), France (ongoing, recruitment ended), Italy (ongoing, recruitment ended), Poland (ongoing, recruitment ended).
Therapeutic area(s): Diseases [C] - Nervous System Diseases [C10]
Gender: Female, Male. Age: 18-64 years, 65+ years. Enrolment: 49.
Start date (EU): 2021-12-08. Decision date: 2024-05-21. Results received: No. Last updated: 2026-06-08.
Decision dates by country: DE: 2024-05-22, IT: 2024-06-03, ES: 2024-05-21, FR: 2024-05-24, PL: 2024-06-14

Condition(s): Neurofibromatosis Type 1 (NF1) with Symptomatic, Inoperable Plexiform Neurofibromas (PN).
Product: SELUMETINIB, Placebo to match Selumetinib capsules, 10 and 25 mg., SELUMETINIB

Primary endpoint: Objective Response Rate (ORR) using volumetric MRI analysis as determined by ICR per REiNS criteria.
Endpoint(s): Change from baseline in chronic target PN pain intensity. Change from baseline in PlexiQoL total score. Objective Response Rate. Duration of Response. Progression Free Survival. Time to progression. Time to Response. Best percentage change from baseline in target PN vol. Pain palliation, pain medication use, pain interference, physical functioning, health related quality of life PROs&health status. Safety&tolerability. Plasma concentrations&PK parameters of selumetinib&Ndesmethyl selumetinib.

Source: https://euclinicaltrials.eu/ctis-public/view/2023-507336-20-00